EU clinical trial 2024-514678-35-00: Randomized, open-label, single-dose, two-period, cross-over, bioequivalence study comparing Linagliptin 5 mg film-coated tablets (Vipharm S.A.) to Trajenta® 5 mg film-coated tablets (Boehringer Ingelheim) in healthy volunteers under fasting conditions.
Protocol code: 974/24
Sponsor: Vipharm S.A. (Pharmaceutical company). Phase: Human Pharmacology (Phase I)- Bioequivalence Study. Countries: Czechia (ended).
Therapeutic area(s): Not possible to specify
Gender: Female, Male. Age: 18-64 years. Enrolment: 46.
Status: Ended. Start date (EU): 2024-11-15. End date (EU): 2025-01-10. Decision date: 2024-09-13. Results received: No. Last updated: 2024-09-13.

Condition(s): Bioequivalence study in healthy volunteers under fasting conditions

Source: https://euclinicaltrials.eu/ctis-public/view/2024-514678-35-00